EU clinical trial 2024-513936-80-00: FILOCLL14 - STAIR : "Open-label, phase 2 study investigating the STop and restart Acalabrutinib In fRrail patients with previously untreated CLL (STAIR)"
Sponsor: French Innovative Leukemia Organization (Laboratory/Research/Testing facility). Phase: Therapeutic exploratory (Phase II). Countries: France (ongoing, recruitment ended).
Therapeutic area(s): Diseases [C] - Hemic and Lymphatic Diseases [C15]
Gender: Female, Male. Age: 65+ years. Enrolment: 160.
Status: Ongoing, recruitment ended. Start date (EU): 2021-11-12. Decision date: 2024-10-28. Results received: No. Last updated: 2026-06-04.

Condition(s): elderly patients (> 70 years) with CLL or SLL
Product: Calquence 100 mg hard capsules, Calquence 100 mg film-coated tablets

Primary endpoint: PFS at 1 year post-ACA discontinuation is defined as the time from randomization to progression (needing therapy or not) or death from any cause. Patients alive and progression-free will be censored at the last disease assessment or at initiation of next treatment. Progression will be evaluated using iwCLL 2018 criteria
Endpoint(s): OS is defined as the time from randomization to death from any cause. Patients alive will be censored at last follow-up news., TTNT is defined as the time from randomization to initiation of next treatment required for symptomatic CLL. Patients without initiation of next treatment will be censored at last follow-up date. This need for restarting therapy will be centrally validated by an independent board review and based on iwCLL 2018 criteria for symptomatic CLL., QoL will be evaluated using the EORTC QLQ-C30 questionnaire, Secondary end point (English), Overall Response Rate (ORR) to re-treatment is defined as the proportion of re-treated patients who achieved best response of complete remission (CR), complete remission with incomplete marrow recovery (CRi), nodular partial remission (nPR), or partial remission (PR) per iwCLL 2018 criteria.

Source: https://euclinicaltrials.eu/ctis-public/view/2024-513936-80-00